EU clinical trial 2024-517649-15-00: Evaluation of ALLERgen Specific Vaccination of DOG Allergic Patients in Swedish Practice - ALLERDOG SWEDEN
Protocol code: ALLERDOG
Sponsor: Karolinska Institutet (Educational Institution). Phase: Therapeutic use (Phase IV). Countries: Sweden (authorised, recruitment pending).
Therapeutic area(s): Diseases [C] - Immune System Diseases [C20]
Gender: Female, Male. Age: 18-64 years. Enrolment: 40.
Status: Authorised, recruitment pending. Decision date: 2025-01-15. Results received: No. Last updated: 2026-01-14.

Condition(s): Allergic rhinitis due to dog allergy
Product: ALUTARD SQ epitel, injektionsvätska, suspension - 553 Hund, Livostin 0,5 mg/ml ögondroppar, suspension, Desloratadine Sandoz 5 mg filmdragerade tabletter, Nasonex 50 mikrogram/dos nässpray, suspension

Primary endpoint: Improvement in Rhinoconjunctivitis Total Symptom Score (RTSS) and visual analogue scale (VAS) registered 30 min after provocation with dog dander before and after one year treatment with Alutard SQ Dog.
Endpoint(s): Occurrence of AEs and SAEs., Conjunctions between levels of total IgE and specific IgE (Can f 1, Can f 2, Can f 4, Can f 5, Can f 6) and the treatment effect of Alutard SQ dog., Improvement of PNIF and PEF after contact with dogs before and after treatment with Alutard SQ Ddog.

Source: https://euclinicaltrials.eu/ctis-public/view/2024-517649-15-00